EU clinical trial 2025-521651-22-00: Prevention of Ribociclib-related hepatotoxicity in breast cancer patients: a phase II, multicentre, open label, single arm trial of Silimarin.
Protocol code: GIM35-RIBOSIL
Sponsor: Fondazione Oncotech Impresa Sociale (Patient organisation/association). Phase: Therapeutic exploratory (Phase II). Countries: Italy (authorised, recruitment pending).
Therapeutic area(s): Not possible to specify
Gender: Female, Male. Age: 18-64 years, 65+ years. Enrolment: 170.
Status: Authorised, recruitment pending. Decision date: 2026-02-17. Results received: No. Last updated: 2026-02-17.

Condition(s): hormone receptor positive, HER2-negative breast cancer
Product: SILIMARIN 200 mg compresse rivestite, Kisqali 200 mg film-coated tablets

Primary endpoint: The incidence rate of Grade ≥ 2 AST/ALT increase from the beginning of the treatment to 6 months
Endpoint(s): The incidence rate of all grade AST/ALT increases, from the beginning of the treatment to 6 months after, compared to historical controls from phase III trials, Time to resolution of grade ≥ 2 AST/ALT increase to grade 1 or below: comparison with historical controls from phase III trials., Time to onset of grade ≥ 2 AST/ALT increase: comparison with historical controls from phase III trials., Dose intensity of Ribociclib + ET throughout the 6 months., Cumulative percentage of permanent discontinuations, dose interruptions and dose adjustments during the 6 months period from the beginning of the treatment., To describe differences in the management of hepatotoxicity and correlate the different strategies to time to resolution of the adverse event

Source: https://euclinicaltrials.eu/ctis-public/view/2025-521651-22-00